EU clinical trial 2024-517340-61-00: Adjuvant chemotherapy with gemcitabine and cisplatin compared to standard of care after curative intent resection of cholangiocarcinoma and muscle invasive gallbladder carcinoma (ACTICCA-1 trial)
Protocol code: ACTICCA-1
Sponsor: University Medical Center Hamburg-Eppendorf (Hospital/Clinic/Other health care facility). Phase: Therapeutic confirmatory (Phase III). Countries: Austria (ended), Germany (ended), Italy (ended), Netherlands (ended).
Therapeutic area(s): Diseases [C] - Neoplasms [C04]
Gender: Female, Male. Age: 18-64 years, 65+ years. Enrolment: 573.
Status: Ended. Start date (EU): 2024-11-19. End date (EU): 2025-12-31. Decision date: 2024-11-12. Results received: No. Last updated: 2025-11-23.
Decision dates by country: AT: 2024-11-15, IT: 2024-11-19, NL: 2024-11-14, DE: 2024-11-12

Condition(s): Patients after curative intent resection of cholangiocarcinoma (intrahepatic, hilar or distal) or muscle invasive gallbladder carcinoma (without evidence of metastatic disease).
Product: CAPECITABINE, GEMCITABINE HYDROCHLORIDE, CISPLATIN

Primary endpoint: Disease free survival (DFS)
Endpoint(s): Disease free survival rate at 24 months (DFSR@24), Recurrence free survival (RFS), Overall survival (OS), Safety and tolerability of adjuvant chemotherapy, Quality of life (QoL), Function of biliodigestive anastomosis (in terms of surgical revision, requirement for PTCD), Rate and severity of biliary tract infections, Patterns of disease recurrence, Locoregional control

Source: https://euclinicaltrials.eu/ctis-public/view/2024-517340-61-00